EU clinical trial 2023-509885-39-00: Pragmatic trial on the safety and tolerability of an optimized dose of rifampicin in tuberculosis patients
Protocol code: PORT
Sponsor: IRCCS Ospedale Sacro Cuore Don Calabria (Hospital/Clinic/Other health care facility). Phase: Therapeutic confirmatory (Phase III). Countries: Netherlands (temporarily halted), Denmark (authorised, recruitment pending), Italy (temporarily halted).
Therapeutic area(s): Diseases [C] - Bacterial Infections and Mycoses [C01]; Diseases [C] - Respiratory Tract Diseases [C08]
Gender: Female, Male. Age: 18-64 years, 65+ years. Enrolment: 130.
Start date (EU): 2024-01-15. Decision date: 2024-01-11. Results received: No. Last updated: 2026-08-06.
Decision dates by country: DK: 2024-01-11, NL: 2024-01-11, IT: 2024-08-12

Condition(s): Tuberculosis
Product: RIFAMPICIN

Primary endpoint: The incidence of hepatotoxicity
Endpoint(s): The proportion of adverse events overall and graded by severity assessed to be related or probably related to rifampicin., Final treatment outcome at the end of treatment according to WHO definitions of cure., Two and three months culture conversion rates, Steady-state plasma pharmacokinetic parameters

Source: https://euclinicaltrials.eu/ctis-public/view/2023-509885-39-00